EU clinical trial 2023-509504-15-00: C4391002 - A PHASE 1B/2, OPEN-LABEL, MULTICENTER, DOSE ESCALATION AND DOSE EXPANSION STUDY TO EVALUATE THE SAFETY, TOLERABILITY, PHARMACOKINETICS, PHARMACODYNAMICS, AND ANTITUMOR ACTIVITY OF PF-07220060 IN COMBINATION WITH PF-07104091 PLUS ENDOCRINE THERAPY IN PARTICIPANTS WITH ADVANCED SOLID TUMORS
Protocol code: C4391002
Sponsor: Pfizer Inc. (Pharmaceutical company). Phase: Therapeutic exploratory (Phase II). Countries: Czechia (ongoing, recruitment ended), Spain (ongoing, recruitment ended), Bulgaria (ongoing, recruitment ended).
Therapeutic area(s): Diseases [C] - Neoplasms [C04]
Gender: Female, Male. Age: 18-64 years, 65+ years. Enrolment: 49.
Status: Ongoing, recruitment ended. Start date (EU): 2023-03-20. Decision date: 2024-06-10. Results received: No. Last updated: 2026-07-17.
Decision dates by country: ES: 2024-06-10, BG: 2024-07-01, CZ: 2024-06-11

Condition(s): HR-positive HER2-negative metastatic/advanced BC
Product: FULVESTRANT, LETROZOLE

Primary endpoint: Part 1: First cycle DLTs., Part 1: AEs as characterized by type, frequency, severity (as graded by NCI CTCAE version 5.0) timing, seriousness, and relationship to study intervention., Part 1: Laboratory abnormalities as characterized by type, frequency, severity (as graded by NCI CTCAE version 5.0), and timing., Part 1: Vital sign abnormalities., Part 1: Heart rate corrected QT interval (eg, QTcF)., Part 2: First cycle DLTs (for the safety run-in)., Part 2: AEs as characterized by type, frequency, severity (as graded by NCI CTCAE version 5.0), timing, seriousness, and relationship to study treatment., Part 2: Laboratory abnormalities as characterized by type, frequency, severity (as graded by NCI CTCAE version 5.0, and timing.
Endpoint(s): Part 1: PK parameters of PF-07220060 and PF-07104091: • Single dose (PF-07104091) - Cmax, Tmax, AUClast, and as data permit, AUCinf, CL/F, Vz/F, and t1/2. • Multiple Dose (PF-07220060 & PF-07104091; assuming steady state is achieved) - Css,max, Tss,max, AUCss,τ, Css,min, CLss/F, and as data permit, Vss/F, t1/2, and Rac (AUCss,τ/AUCsd,τ) for PF-07104091., Part 1: AEs as characterized by type, frequency, severity (as graded by NCI CTCAE version 5.0) timing, seriousness, and relationship to study intervention., Part 1: Laboratory abnormalities as characterized by type, frequency, severity (as graded by NCI CTCAE version 5.0), and timing., Part 1: • ORR, as assessed using RECIST version 1.1., Part 1: TTE endpoints: eg, DoR, PFS, and TTP., Part 2: ORR and CBR as assessed using RECIST version 1.1., Part 2: TTE endpoints: DoR, PFS, and TTP., Part 2: Concentrations of PF-07220060 and PF-07104091 at selected time points.

Source: https://euclinicaltrials.eu/ctis-public/view/2023-509504-15-00